EU clinical trial 2024-519820-26-00: A Randomized, Double-Blind, Placebo-Controlled Study to Assess the Efficacy and Safety of ML-007C-MA for the Treatment of Hallucinations and Delusions Associated with Alzheimer’s Disease Psychosis
Protocol code: ML-007C-MA-221
Sponsor: Maplight Therapeutics Inc. (Pharmaceutical company). Phase: Therapeutic exploratory (Phase II). Countries: France (ongoing, recruiting), Czechia (authorised, recruiting), Slovakia (authorised, recruiting), Hungary (authorised, recruiting), Portugal (authorised, recruiting), Romania (authorised, recruiting), Bulgaria (ongoing, recruiting), Italy (authorised, recruiting), Poland (authorised, recruiting).
Therapeutic area(s): Diseases [C] - Nervous System Diseases [C10]
Gender: Female, Male. Age: 18-64 years, 65+ years. Enrolment: 78.
Start date (EU): 2026-01-22. Decision date: 2025-10-27. Results received: No. Last updated: 2026-04-27.
Decision dates by country: BG: 2025-11-03, FR: 2025-10-27, IT: 2025-10-30, RO: 2025-11-03, PL: 2025-10-31, CZ: 2025-10-29, SK: 2025-10-29, PT: 2025-10-28, HU: 2025-10-31

Condition(s): Hallucinations and Delusions Associated with Alzheimer’s Disease Psychosis
Product: Placebo for ML-007C-MA bilayer tablet

Primary endpoint: Change from Baseline to Week 7 in the NPI-C H+D score
Endpoint(s): Change from Baseline to Week 7 in the CGI-S hallucinations and delusions domain-specific score, Change from Baseline to Week 7 in the NPI-C A+A score in participants who have a CGI-S agitation/aggression domain-specific score of ≥4 at Baseline, CGI-C hallucinations and delusions domain-specific score at Week 7, Change from Baseline to Week 7 on the NPI-C Hallucinations score, Change from Baseline to Week 7 on the NPI-C Delusions score, NPI-C H+D response, defined as ≥30% decrease in NPI-C H+D score at Week 7 relative to Baseline, Change from Baseline to Week 7 on the caregiver distress score of the hallucinations + delusions domains of the NPI-C

Source: https://euclinicaltrials.eu/ctis-public/view/2024-519820-26-00